EU clinical trial 2024-516196-32-00: Substantially improving the cure rate of high-risk BRCA1-like breast cancer patients with personalized therapy (SUBITO) - an international randomized phase III trial
Sponsor: Het Nederlands Kanker Instituut-Antoni van Leeuwenhoek Ziekenhuis Stichting (Hospital/Clinic/Other health care facility). Phase: Therapeutic confirmatory (Phase III). Countries: Netherlands (ongoing, recruiting), France (ongoing, recruiting).
Therapeutic area(s): Diseases [C] - Neoplasms [C04]
Gender: Female, Male. Age: 18-64 years, 65+ years. Enrolment: 172.
Status: Ongoing, recruiting. Start date (EU): 2017-01-01. Decision date: 2025-01-23. Results received: No. Last updated: 2026-05-28.
Decision dates by country: FR: 2025-01-29, NL: 2025-01-23

Condition(s): breast cancer, Stage III
Product: DOXORUBICINE TEVA 50 mg/25 ml, solution injectable, Cyclofosfamide Sandoz 1000 mg, poeder voor oplossing voor injectie/infusie, Thiotepa Fresenius Kabi 15 mg poeder voor concentraat voor oplossing voor infusie, Paclitaxel Aurobindo 6 mg/ml, concentraat voor oplossing voor infusie., Lynparza 150 mg film-coated tablets, Capecitabine Sandoz 150 mg, filmomhulde tabletten, Lynparza 100 mg film-coated tablets, Carboplatin Accord 10 mg/ml concentraat voor oplossing voor infusie

Primary endpoint: Overall survival, defined as the time from randomization to death from any cause in all patients.
Endpoint(s): Key secondary endpoint: Overall survival, defined as the time from randomization to death from any cause in patients without a germline BRCA1/2 mutation., Recurrence-free interval, defined as time from randomization to invasive ipsilateral breast tumor recurrence, locoregional- or distant recurrence, or death from breast cancer, whichever comes first, in all patients, regardless of germline BRCA1/2 status., Recurrence-free interval defined as time from randomization to invasive ipsilateral breast tumor recurrence, locoregional- or distant recurrence, or death from breast cancer, whichever comes first, in patients with an HR impaired tumor (i.e. harboring a BRCA1-like copy number profile or BRCA1 promotor hypermethylation, in the absence of a known germline BRCA1/2 mutation)., (non-)hematological toxicity determined according to CTCAE v4.03., cost-effectiveness measured by costs per quality-adjusted life years (QALYs) and incremental cost-effectiveness ratio (ICER)., Patient reported outcomes; including an interview, quality of life (QoL) determined by a comprehensive panel of QoL questionnaires and cognitive function, Several potential biomarkers, The difference in overall survival between patients treated in the SUBITO trial and patients with the same characteristics treated outside of the trial in the Netherlands (using data from the Netherlands Cancer Registry (NCR)).

Source: https://euclinicaltrials.eu/ctis-public/view/2024-516196-32-00